EU clinical trial 2024-513607-14-00: IMLIFIDASE IN LIVING DONOR RENAL TRANSPLANTATION: HIGHLY SENSITIZED RECIPIENTS (LIVEDES STUDY)
Protocol code: Livedes study
Sponsor: Fundacio De Recerca Clinic Barcelona-Institut D’Investigacions Biomediques August Pi I Sunyer (Laboratory/Research/Testing facility). Phase: Therapeutic exploratory (Phase II). Countries: Spain (ended).
Therapeutic area(s): Phenomena and Processes [G] - Reproductive and Urinary Physiological Phenomena [G08]
Gender: Female, Male. Age: 18-64 years. Enrolment: 10.
Status: Ended. End date (EU): 2024-12-03. Decision date: 2024-10-22. Results received: No. Last updated: 2024-10-22.

Condition(s): kidney trasplant
Product: IMLIFIDASE

Primary endpoint: Proportion of patients with conversion of a positive virtual crossmatch to negative within 6 hours after imlifidase treatment (up to two doses).
Endpoint(s): To evaluate flow cytometry T-cell crossmatch conversion within 24 hours of imlifidase treatment, requirement of a second dose of imlifidase., To evaluate the rebound of preexisting donor specific antibodies (DSA) (difference between MFI of each DSA daily - until D+14 - compared to pre-imlifidase administration), To evaluate the appearance of de novo DSAs (any DSA no present in pre-transplant or historical) daily - until D+14. To be considered positive the bead MFI should be over 750 and to be above the bead specific threshold related to the lowest bead of the same locus., HLA/DSA antibody levels at several time points between pre-dose imlifidase and 2 weeks, and at 1, 3 and 6 months and 1 year after imlifidase treatment, Renal function at several time points between 24 hours and 2 weeks and at 1, 3 and 6 months and 1 year after transplantation as assessed by estimated glomerular filtration rate (eGFR) and serum/plasma creatinine levels, To evaluate patient survival 1 year after transplantation, To evaluate the graft survival at 12 months (both overall and death-censored analysis), To evaluate the incidence of acute allograft rejection within 12 months (overall and stratified by type: cell mediated rejection or antibody-mediated rejection), To evaluate safety of Imlifidase treatment with regards to infusion related reactions occurring within 48 hours of Imlifidase infusion, To evaluate the adverse events within 30 days after transplantation, To evaluate to severe or serious infections (that required hospitalization) within 30 days after transplantion, at 6 and 12 months, To evaluate safety of Imlifidase treatment with regards to reported serious adverse events (SAEs)

Source: https://euclinicaltrials.eu/ctis-public/view/2024-513607-14-00